EU clinical trial 2025-524987-39-00: A Phase 1b, Double-Blind Study to Investigate Safety, Tolerability, Pharmacokinetics, Efficacy, and Pharmacodynamics of Single Dose of ATI-052 in Participants with Mild to Moderate Asthma
Protocol code: ATI-052-ASTH-101
Sponsor: Aclaris Therapeutics Inc. (Pharmaceutical company). Phase: Human Pharmacology (Phase I)- Other. Countries: Germany (ongoing, recruiting).
Therapeutic area(s): Diseases [C] - Respiratory Tract Diseases [C08]
Gender: Female, Male. Age: 18-64 years, 65+ years. Enrolment: 10.
Status: Ongoing, recruiting. Start date (EU): 2026-05-04. Decision date: 2026-04-16. Results received: No. Last updated: 2026-06-03.

Condition(s): Mild to Moderate Asthma

Source: https://euclinicaltrials.eu/ctis-public/view/2025-524987-39-00